EU clinical trial 2024-518891-29-00: A randomized, run-in, phase II study of nivolumab combined with ipilimumab and oral decitabine/cedazuridine (ASTX727) or nivolumab combined with ipilimumab in melanoma and NSCLC patients resistant to anti-PD-1/PD-L1
Protocol code: NIBIT-ML-1
Sponsor: Fondazione NIBIT Onlus (Laboratory/Research/Testing facility). Phase: Therapeutic exploratory (Phase II). Countries: Italy (ongoing, recruiting).
Therapeutic area(s): Diseases [C] - Neoplasms [C04]
Gender: Female, Male. Age: 18-64 years, 65+ years. Enrolment: 148.
Status: Ongoing, recruiting. Start date (EU): 2024-11-18. Decision date: 2024-11-18. Results received: No. Last updated: 2026-01-28.

Condition(s): MM and NSCLC patients resistant to anti-PD-1/PD-L1 therapy
Product: ASTX727, YERVOY 5 mg/ml concentrate for solution for infusion, OPDIVO 10 mg/mL concentrate for solution for infusion.

Primary endpoint: Tumor assessment, using the immune-related response criteria iRECIST, is made by the investigator., Tumor assessment, using the immune-related response criteria iRECIST, is made by the investigator.
Endpoint(s): Endpoints for safety profile include an evaluation of AEs, SAEs, laboratory evaluations, vital signs and physical examination., Objective Response Rate (ORR) is the proportion of treated subjects with a BOR of CR or PR per RECIST 1.1., Disease Control Rate (DCR) is the proportion of treated subjects with a BOR of confirmed CR, confirmed PR or SD, based on RECIST 1.1 and iRECIST., Time to Response (TTR) is defined as the time from first dosing date until the measurement criteria are first met for overall response of PR or CR (whichever status comes first, and provided it is subsequently confirmed), , based on RECIST 1.1 and iRECIST., Duration of Response (DoR) for the subjects whose BOR is CR or PR will be defined as the time between the date of response of confirmed CR or confirmed PR (whichever occurs first) and the date of PD or death (whichever occurs first), , based on RECIST 1.1 and iRECIST.The onset of a confirmed CR or PR is determined by the initial assessment of response, not by the confirmatory assessment., Progression-free Survival (PFS): Progression free survival (PFS) per RECIST 1.1 and iRECIST will be defined as the time between the date of randomization and the date of progression and or confirmed PD (according to RECIST 1.1 and iRECIST) or death, whichever occurs first., Overall Survival (OS): Overall Survival (OS) is defined as the time from randomization until the date of death. For those subjects who have not died, OS will be censored at the recorded last date of subject contact, and for subjects with a missing recorded last date of contact, OS will be censored at the last date the subject was known to be alive. Any efforts will be made to know the date of death.

Source: https://euclinicaltrials.eu/ctis-public/view/2024-518891-29-00